EU clinical trial 2024-512448-41-00: An Open Label Follow-Up Study to Evaluate the Long Term Safety and Efficacy of L-CSA in Patients with a Diagnosis of CLAD-BOS after they have completed the participation to BOSTON 1 and BOSTON 2 studies
Protocol code: BT–L-CsA–303–FU
Sponsor: Zambon S.p.A. (Pharmaceutical company). Phase: Therapeutic confirmatory (Phase III). Countries: Spain (ended), Germany (ended), Austria (ended), Belgium (ended), Denmark (ended), France (ended).
Therapeutic area(s): Diseases [C] - Respiratory Tract Diseases [C08]
Gender: Female, Male. Age: 18-64 years, 65+ years. Enrolment: 81.
Status: Ended. Start date (EU): 2020-04-01. End date (EU): 2026-02-25. End date: 2026-02-26. Decision date: 2024-07-25. Results received: No. Last updated: 2026-04-06.
Decision dates by country: AT: 2024-07-30, BE: 2024-07-29, DK: 2024-07-30, DE: 2024-07-30, FR: 2024-07-25, ES: 2024-07-29

Condition(s): Bronchiolitis Obliterans Syndrome in Patients post Single or post Double Lung Transplantation
Product: Liposomal Ciclosporin A, Liposomal Ciclosporin A

Primary endpoint: SAFETY: Adverse events (AEs), SAFETY: Acute tolerability of IMP after initial dosing (only in patients randomized to SoC in BOSTON-1 or BOSTON-2 study), SAFETY: Clinical laboratory parameters, SAFETY: Vital signs, SAFETY: Physical examinations, SAFETY: Renal function, EFFICACY: Mean change in forced expiratory volume in 1 second (FEV1) (mL) from baseline to approximately each year until End of Study, EFFICACY: Mean change in FEV1/forced vital capacity (FVC) from baseline to approximately each year until End of Study, EFFICACY: Time to progression of BOS, defined as the earliest of the following: o Absolute decrease from baseline in FEV1 ≥ 10% or ≥ 200 mL and absolute decrease in FEV1/FVC of > 5%, OR o Worsening of BOS grade (according to criteria in Verleden 2019), OR o Re-transplantation, OR o Death from respiratory failure, EFFICACY: Rate of decline of FEV1 from baseline to last treatment day, EFFICACY: Use of additional immunosuppressive therapy, EFFICACY: Proportion of patients experiencing re-transplantation due to BOS, EFFICACY: Proportion of patients with fatal outcome due to respiratory failure, EFFICACY: Change in BOS severity (according to criteria in Verleden 2019), EFFICACY: Mean relative intra-individual change of FEV1 between start of treatment (baseline) and end of study participation, EFFICACY: Euro Quality of Life Questionnaire (EQ-5D-5L), EFFICACY: Hospitalization days, EFFICACY: Absolute and relative change from baseline in: o Forced mid-expiratory flow (FEF25-75) o Forced Vital Capacity (FVC)

Source: https://euclinicaltrials.eu/ctis-public/view/2024-512448-41-00